EU clinical trial 2023-505830-89-00: (20510) A Phase 4, randomized, open-label, multicenter efficacy and safety study of standard dose of radium-223 dichloride vs. standard doses of androgen receptor pathway inhibitor (ARPI) in patients with bone dominant metastatic castration resistant prostate cancer (mCRPC) progressing on/after one line of ARPI
Protocol code: 20510
Sponsor: Bayer Consumer Care AG, Bayer AG (Pharmaceutical company). Phase: Therapeutic use (Phase IV). Countries: Italy (ongoing, recruitment ended), Poland (ongoing, recruitment ended), Lithuania (ongoing, recruitment ended), Austria (ongoing, recruitment ended), Hungary (ended), France (ongoing, recruitment ended), Finland (ended), Germany (ongoing, recruitment ended), Czechia (ongoing, recruitment ended), Spain (ongoing, recruitment ended).
Therapeutic area(s): Diseases [C] - Neoplasms [C04]
Gender: Male. Age: 18-64 years, 65+ years. Enrolment: 514.
Start date (EU): 2020-08-05. Decision date: 2024-02-08. Results received: No. Last updated: 2026-07-29.
Decision dates by country: FI: 2024-02-08, HU: 2024-02-08, CZ: 2024-02-08, FR: 2024-02-12, DE: 2024-02-09, ES: 2024-02-08, AT: 2024-02-12, LT: 2024-02-14, PL: 2024-03-07, IT: 2024-02-12

Condition(s): metastatic castrate resistant prostate cancer (mCRPC)
Product: ZYTIGA 500 mg film-coated tablets, DELTACORTENE 5 mg compresse, Xofigo 1100 kBq/mL solution for injection, Prednisolone 5mg Tablets, Xtandi - 40 mg soft capsules

Primary endpoint: Overall survival (OS)
Endpoint(s): Time to first symptomatic skeletal event (SSE), Radiological Progression-free survival (rPFS), Time to pain progression (BPI-SF), Adverse events assessments using NCI CTCAE (V5.0), Incidence of fractures, Time to deterioration of FACT-P total score

Source: https://euclinicaltrials.eu/ctis-public/view/2023-505830-89-00